EU clinical trial 2023-505743-38-00: Phase 0 lead-in trial of Pitavastatin in primary and recurrent Glioblastoma patients
Protocol code: 10227
Sponsor: Erasmus Universitair Medisch Centrum Rotterdam (Erasmus MC) (Hospital/Clinic/Other health care facility). Phase: Human Pharmacology (Phase I)- Other. Countries: Netherlands (ended).
Therapeutic area(s): Diseases [C] - Neoplasms [C04]; Diseases [C] - Nervous System Diseases [C10]
Gender: Female, Male. Age: 18-64 years, 65+ years. Enrolment: 18.
Status: Ended. Start date (EU): 2024-01-18. End date (EU): 2024-07-19. Decision date: 2023-10-16. Results received: No. Last updated: 2023-10-16.

Condition(s): Glioblastoma Multiforme

Source: https://euclinicaltrials.eu/ctis-public/view/2023-505743-38-00